EU clinical trial 2022-500445-24-00: A Multicenter, Randomized, Double-Blind, Placebo-Controlled, 2-Stage Trial to Evaluate Efficacy and Safety of Telitacicept Compared to Placebo in Patients with Moderately to Severely Active Systemic Lupus Erythematosus (REMESLE-1)
Protocol code: RC18G001
Sponsor: Remegen Co. Ltd. (Pharmaceutical company). Phase: Therapeutic confirmatory (Phase III). Countries: Bulgaria (ended), Poland (ended), Spain (ended), France (not authorised), Czechia (not authorised), Germany (ended), Hungary (ended).
Therapeutic area(s): Diseases [C] - Immune System Diseases [C20]
Gender: Female, Male. Age: 18-64 years, 65+ years. Enrolment: 146.
Status: Ended. Start date (EU): 2022-11-30. End date (EU): 2025-01-31. End date: 2025-02-01. Decision date: 2022-09-23. Results received: No. Last updated: 2025-01-21.
Decision dates by country: FR: 2022-09-26, DE: 2023-02-09, HU: 2023-01-10, PL: 2022-09-26, ES: 2022-09-23, BG: 2022-09-26

Condition(s): Moderately to Severely Active Systemic Lupus Erythematosus
Product: Telitacicept injection, Placebo for telitacicept

Primary endpoint: Stage 1: The proportion of patients achieving a response in an SLE Responder Index (SRI-4) at Week 52; Safety and tolerability of telitacicept 160 mg and 240 mg in adult patients with active SLE; PK and PD of telitacicept 160 mg and 240 mg when administered as a subcutaneous injection via prefilled syringes in adult patients with active SLE., Stage 2: The proportion of subjects achieving an SLE Responder Index (SRI-4) at Week 52.
Endpoint(s): Stage 1: The proportion of adult patients achieving a response in an SLE Responder Index (SRI-4) at Week 24., Stage 2: The proportion of subjects achieving a BILAG-based Combined Lupus Assessment (BICLA) response at week 52, Stage 2: Among subjects who were on an average daily dose of >7.5 mg/day prednisone or equivalent at baseline, the proportion of those subjects achieving a GC dose reduction of ≥25% from baseline to ≤7.5 mg/day prednisone or equivalent by Week 40 and maintaining that dose through Week 52., Stage 2: Time to flare assessed by SFI from baseline through Week 52, Stage 2: The proportion of subjects achieving an SRI-4 response at Week 52, while maintaining an average daily dose of ≤7.5 prednisone or equivalent between Week 40 and Week 52.

Source: https://euclinicaltrials.eu/ctis-public/view/2022-500445-24-00